EU clinical trial 2024-516846-20-00: Randomised Placebo-Controlled Trial of Early Targeted Treatment of Patent Ductus Arteriosus with Paracetamol in Extremely Low Birth Weight Infants (ETAPA)
Sponsor: University College Dublin (Educational Institution). Phase: Therapeutic confirmatory (Phase III). Countries: Czechia (ongoing, recruiting), Ireland (ongoing, recruiting).
Therapeutic area(s): Diseases [C] - Congenital, Hereditary, and Neonatal Diseases and Abnormalities [C16]; Diseases [C] - Cardiovascular Diseases [C14]
Gender: Female, Male. Age: 0-17 years. Enrolment: 228.
Status: Ongoing, recruiting. Start date (EU): 2021-09-26. Decision date: 2024-09-03. Results received: No. Last updated: 2025-10-29.
Decision dates by country: CZ: 2024-09-05, IE: 2024-09-03

Condition(s): Patent Ductus Arteriosus
Product: Sodium Chloride 0.9% w/v Intravenous Infusion BP Solution for Infusion, Paracetamol 10mg/ml solution for infusion

Primary endpoint: The primary endpoint of PIVH ≥grade II, NEC ≥grade IIa (Bell's staging), and death will be assessed at discharge.
Endpoint(s): The secondary endpoint of CLD will be assessed at 36 weeks CGA. All other secondary endpoints will be assessed at discharge home, apart from developmental outcome at 2 years of corrected gestational age which will be assessed by Bayley’s assessment as phase 3 of ETAPA trial (and is not part of this protocol)

Source: https://euclinicaltrials.eu/ctis-public/view/2024-516846-20-00